EU clinical trial 2024-512761-13-00: Remyelination in Multiple Sclerosis: a PET-MR longitudinal study investigating individual profiles of myelin repair and the contribution of neuroinflammation (SMART in MS)
Protocol code: APHP200056
Sponsor: Assistance Publique Hopitaux De Paris (Hospital/Clinic/Other health care facility). Phase: Therapeutic confirmatory (Phase III). Countries: France (authorised, recruiting).
Therapeutic area(s): Diseases [C] - Nervous System Diseases [C10]
Gender: Female, Male. Age: 18-64 years. Enrolment: 60.
Status: Authorised, recruiting. Start date (EU): 2022-01-24. Decision date: 2024-12-03. Results received: No. Last updated: 2025-04-24.

Condition(s): Remyelination in Multiple Sclerosis

Source: https://euclinicaltrials.eu/ctis-public/view/2024-512761-13-00